EU clinical trial 2023-506515-18-00: A Phase IIIB Multicenter, Randomized, Double-Blind, Controlled Study to Evaluate the Efficacy, Safety and Pharmacokinetics of a Higher Dose of Ocrelizumab in Adults with Primary Progressive Multiple Sclerosis
Protocol code: BN42083
Sponsor: F. Hoffmann-La Roche AG (Pharmaceutical company). Phase: Therapeutic confirmatory (Phase III). Countries: Greece (ended), Hungary (ended), Italy (ongoing, recruitment ended), Spain (ended), France (ended), Bulgaria (ongoing, recruitment ended), Belgium (ended), Portugal (ended), Poland (ongoing, recruitment ended), Denmark (ended), Germany (ongoing, recruitment ended).
Therapeutic area(s): Diseases [C] - Nervous System Diseases [C10]
Gender: Female, Male. Age: 18-64 years. Enrolment: 310.
Start date (EU): 2020-10-23. Decision date: 2024-02-08. Results received: No. Last updated: 2026-05-11.
Decision dates by country: PL: 2024-02-09, IT: 2024-02-12, HU: 2024-02-08, BE: 2024-02-13, DE: 2024-02-09, FR: 2024-02-13, GR: 2024-03-20, BG: 2024-03-25, PT: 2024-02-09, DK: 2024-02-09, ES: 2024-02-12

Condition(s): Primary Progressive Multiple Sclerosis (PPMS)
Product: Placebo Ocrelizumab, Paracetamol 500mg Tablets, Methylprednisolone 500 mg powder and solvent for solution for injection/infusion, Ocrevus 300 mg concentrate for solution for infusion, Ocrevus 300 mg concentrate for solution for infusion, Diphenhydramine Hydrochloride Tablets 50 mg

Primary endpoint: 1. Time to onset of cCDP sustained for at least 12 weeks. Time to onset of cCDP is defined as the first occurrence of a predefined confirmed progression event measured by EDSS, T25FWT or 9-HPT
Endpoint(s): 1. Time to onset of 24 week cCDP (cCDP24), 2. Time to onset of cCDP12 independent of protocol-defined relapses (PDR), also termed progression independent of relapse activity (PIRA) as per Kappos et al.2020, 3. Time to onset of 12-week CDP (CDP12), 4. Time to ≥ 20% increase in 12 week confirmed T25FWT, 5. Annual rate of percent change from baseline in total brain volume, 6. Annual rate of percent change from baseline in thalamic volume, 7. Time to 12-week confirmed 4-point worsening in Symbol Digit Modalities Test (SDMT), 8. Change in NfL (i.e. ratio to baseline) at Week 96, 9.Time to 12-week confirmed 8-point increase in 12-Item Multiple Sclerosis Walking Scale (MSWS12), 10. Change in NfL (i.e. ratio to baseline) at Week 96 for patients in the higher dose ocrelizumab group, 11. Change in NfL (i.e. ratio to baseline) at Week 96 for patients in the approved dose ocrelizumab group, 12. Incidence and severity of adverse events, with severity determined according to the National Cancer Institute Common Terminology Criteria for Adverse Events (NCI CTCAE) Version 5.0, 13. Change from baseline in clinical laboratory test results (including hematology, chemistry, and Ig levels), 14. Change from baseline in vital signs (including systolic and diastolic blood pressure, and pulse rate) following study treatment administration, 15. Serum concentration of ocrelizumab at specified timepoints, 16. B-cell levels in blood (including comparing the degree of B-cell depletion between the doses), 17. Proportion of participants achieving 5 or less B-cells per microliter of blood, 18. Proportion of participants achieving 5 or less B-cells per microliter of blood in participants with the high versus low affinity Fcgamma Receptor 3A (FcγR3A) genotype per arm, 19. Change from Baseline in the anti-drug antibodies (ADAs) levels, 20. Levels of Neurofilament Light Chain (NfL) in blood, 21. Levels of Interleukin-6 (IL-6) in blood, 22. Levels of blood B-cells, 23. Levels of Lymphocytes in blood, 24. Proportion of participants with different DNA genotypes

Source: https://euclinicaltrials.eu/ctis-public/view/2023-506515-18-00